EU clinical trial 2022-502548-12-00: A Phase 3 Randomized, Open-Label, Multicenter Study of Zanubrutinib (BGB 3111) Plus Anti-CD20 Antibodies Versus Lenalidomide Plus Rituximab in Patients With Relapsed/Refractory Follicular or Marginal Zone Lymphoma
Protocol code: BGB-3111-308
Sponsor: BeOne Medicines AG (Pharmaceutical company). Phase: Therapeutic confirmatory (Phase III). Countries: Czechia (ongoing, recruitment ended), Romania (ongoing, recruitment ended), Austria (ongoing, recruitment ended), Italy (ongoing, recruitment ended), Ireland (ongoing, recruitment ended), Spain (ongoing, recruitment ended), France (ongoing, recruitment ended), Belgium (ongoing, recruitment ended), Bulgaria (ongoing, recruitment ended), Germany (ended), Greece (ongoing, recruitment ended), Portugal (ongoing, recruitment ended), Netherlands (ended), Poland (ongoing, recruitment ended).
Therapeutic area(s): Diseases [C] - Hemic and Lymphatic Diseases [C15]
Gender: Female, Male. Age: 18-64 years, 65+ years. Enrolment: 316.
Start date (EU): 2023-09-28. Decision date: 2023-08-14. Results received: No. Last updated: 2026-03-04.
Decision dates by country: NL: 2024-02-29, DE: 2024-03-22, AT: 2023-08-14, CZ: 2023-08-18, IT: 2023-08-16, PT: 2024-03-13, PL: 2024-04-05, GR: 2024-04-08, IE: 2023-08-21, BG: 2024-04-08, ES: 2023-08-17, BE: 2024-03-26, RO: 2023-08-21, FR: 2023-08-18

Condition(s): marginal zone lymphoma, follicular lymphoma
Product: OBINUTUZUMAB, LENALIDOMIDE, LENALIDOMIDE, RITUXIMAB, RITUXIMAB, Zanubrutinib

Primary endpoint: R/R FL cohort: Progression-free survival (PFS) assessed by a Blinded Independent Review Committee (BIRC) in accordance with the 2014 modification of the International Working Group on non-Hodgkin lymphoma (NHL) Criteria (Lugano 2014 criteria) based on positron emission tomography and computed tomography (PET/CT based Lugano 2014 criteria) (Cheson et al 2014), R/R MZL cohort: PFS assessed by BIRC in accordance with CT based Lugano 2014 criteria
Endpoint(s): R/R FL cohort: Overall response rate (ORR) assessed by BIRC in accordance with PET/CT-based Lugano 2014 criteria., R/R FL cohort: Overall survival (OS), R/R MZL cohort: ORR determined by BIRC (CT based Lugano 2014 criteria), R/R FL cohort: PFS by investigator, ORR by Investigator, Duration of response (DOR), Complete response rate (CRR), time to response (TTR) and time to next anti-lymphoma treatment (TTNT) with PET/CT based Lugano 2014 criteria, R/R MZL cohort: OS, PFS by investigator, ORR by Investigator, DOR, CRR, TTR, TTNT with PET/CT based and CT based Lugano 2014 criteria, R/R FL and R/R MZL cohorts: Patient-reported outcomes (PROs) questionnaires: the European Organization for Research on Treatment of Cancer Quality of Life Questionnaire-Core 30 [EORTC QLQ-C30], National Comprehensive Cancer Network/Functional Assessment of Cancer Therapy Lymphoma Symptom Index-18 [FLymSI 18], and European Quality of Life 5Dimension 5Level Questionnaire [EQ 5D 5L), R/R FL and R/R MZL cohorts: Incidence rate of adverse event, lab abnormalities, and vitals.

Source: https://euclinicaltrials.eu/ctis-public/view/2022-502548-12-00